EU clinical trial 2025-522371-29-00: A Modular Phase I/II Open-label, Multicenter Study to Evaluate the Safety, Pharmacokinetics, Pharmacodynamics, Immunogenicity, and Efficacy of AZD4512 Monotherapy or in Combination With Other Anticancer Agent(s), in Participants With Relapsed/Refractory B-cell Non-Hodgkin Lymphoma (B-NHL) (Lumi-NHL)
Protocol code: D9890C00001
Sponsor: AstraZeneca AB (Pharmaceutical company). Phase: Phase I and Phase II (Integrated)- First administration to humans. Countries: Italy (ongoing, recruiting).
Therapeutic area(s): Diseases [C] - Hemic and Lymphatic Diseases [C15]
Gender: Female, Male. Age: 18-64 years, 65+ years. Enrolment: 18.
Status: Ongoing, recruiting. Start date (EU): 2025-12-19. Decision date: 2025-11-18. Results received: No. Last updated: 2026-08-03.

Condition(s): Non-Hodgkin lymphoma (NHL)
Product: AZD4512

Primary endpoint: Percentage of participants with DLT during the DLT period, Frequency, duration, severity of TEAEs and TRAEs and SAEs, SAEs/AEs leading to discontinuation of AZD4512, Clinically significant alterations in vital signs and abnormal laboratory parameters
Endpoint(s): Response assessment according to Lugano classification (Cheson et al 2014) for malignant lymphoma: ORR, CR rate, DoR and PFS, Overall survival, Plasma concentrations of AZD4512, total antibody and total unconjugated warhead, Plasma PK parameters of AZD4512, total antibody and total unconjugated warhead but not limited to AUC, Cmax, tmax, Ctrough t1/2, and clearance as data allow, The number and percentage of participants who develop ADAs

Source: https://euclinicaltrials.eu/ctis-public/view/2025-522371-29-00